EU clinical trial 2023-504416-16-00: A Phase 3, Randomized, Double-Blind, Placebo-Controlled, Parallel Group Study to Evaluate the Safety and Efficacy of KarXT for the Treatment of Psychosis Associated with Alzheimer’s Disease (ADEPT-2)
Protocol code: KAR-032
Sponsor: Karuna Therapeutics Inc. (Pharmaceutical company). Phase: Therapeutic confirmatory (Phase III). Countries: Poland (ongoing, recruitment ended), Greece (ended), Belgium (ended), Hungary (ended).
Therapeutic area(s): Psychiatry and Psychology [F] - Mental Disorders [F03]; Diseases [C] - Nervous System Diseases [C10]
Gender: Female, Male. Age: 18-64 years, 65+ years. Enrolment: 186.
Start date (EU): 2024-04-11. Decision date: 2024-02-21. Results received: No. Last updated: 2026-05-11.
Decision dates by country: HU: 2024-02-21, GR: 2024-02-23, BE: 2024-02-21, PL: 2024-02-25

Condition(s): Psychosis Associated with Alzheimer’s Disease

Primary endpoint: Change in NPI-C: H+D score
Endpoint(s): •Change in the CGI-S scale: CGI-S requires the assessor to consider aspects of the psychosis (hallucinations and delusions) prior to providing a global assessment of severity, •Change in the: - NPI-C Core score: hallucinations, delusions, agitation, and aggression domains - NPI-C: Agitation score - NPI-C Core score: Caregiver Distress scale (Hallucinations, Delusions, Agitation, and Aggression domains), •Responder rate defined as NPI-C: H+D score ≥ 40% improvement

Source: https://euclinicaltrials.eu/ctis-public/view/2023-504416-16-00